EU clinical trial 2024-519378-37-00: Development and delivery of personalized 3D-printed drugs to improve treatment adherence in children with rare diseases.
Protocol code: IMPRIMIDO
Sponsor: Fundacion Publica Galega Instituto De Investigacion Sanitaria De Santiago De Compostela (Hospital/Clinic/Other health care facility). Phase: Therapeutic confirmatory (Phase III). Countries: Spain (authorised, recruitment pending).
Therapeutic area(s): Diseases [C] - Nutritional and Metabolic Diseases [C18]
Gender: Female, Male. Age: 0-17 years. Enrolment: 14.
Status: Authorised, recruitment pending. Decision date: 2025-03-12. Results received: No. Last updated: 2025-03-12.

Condition(s): Metilcrotonilglicinuria, biotinidasa deficit
Product: BIOTIN, Medebiotin Fuerte solución inyectable, Medebiotín Fuerte Comprimidos

Primary endpoint: visual scale and in the collection of subjective symptoms reported by the patient.
Endpoint(s): Determination of organic acids, plasma biotin levels

Source: https://euclinicaltrials.eu/ctis-public/view/2024-519378-37-00